EU clinical trial 2024-513128-40-00: A Phase 2, Randomized, Double-Blinded, Placebo-Controlled, Study to Evaluate Safety, Tolerability, Pharmacometrics, and Efficacy of DNTH103 in Adults with Multifocal Motor Neuropathy (MOMENTUM)
Protocol code: DNTH103-MMN-201
Sponsor: Dianthus Therapeutics Inc. (Laboratory/Research/Testing facility). Phase: Therapeutic exploratory (Phase II). Countries: Spain (ongoing, recruitment ended), Italy (ongoing, recruitment ended), Denmark (ongoing, recruitment ended), Poland (ongoing, recruitment ended), France (ongoing, recruitment ended), Netherlands (ongoing, recruiting).
Therapeutic area(s): Diseases [C] - Immune System Diseases [C20]
Gender: Female, Male. Age: 18-64 years, 65+ years. Enrolment: 11.
Start date (EU): 2025-02-06. Decision date: 2024-12-17. Results received: No. Last updated: 2026-03-23.
Decision dates by country: ES: 2024-12-17, FR: 2024-12-18, DK: 2024-12-23, PL: 2024-12-19, NL: 2025-06-02, IT: 2024-12-19

Condition(s): Multifocal Motor Neuropathy
Product: DNTH103, Matching placebo to DNTH103

Primary endpoint: Incidence of treatment-emergent adverse events (TEAEs) and treatment emergent serious adverse events (SAEs)
Endpoint(s): Time to retreatment with immunoglobulin (Ig) since the final Ig treatment before randomization, Time to clinical deterioration (CD), Mean value, mean change, and percentage change from baseline in grip strength, Area under curve (AUC) of the change from baseline in grip strength, AUC of the change from baseline in Medical Research Council (MRC)-10 sum score, Mean value and mean change from baseline in MRC-10 sum score, Mean value and mean change from baseline in MRC-14 sum score, Mean value and mean change from baseline in Multifocal Motor Neuropathy Rasch-Built Overall Disability Scale (MMN-RODS) score, Mean value and mean change from baseline in average time to complete the 9-Hole Peg Test (9-HPT), Mean change from baseline in adjusted Inflammatory Neuropathy Cause and Treatment (INCAT) Disability score, Mean change from baseline in Euro-Quality of Life 5 Dimensions 5 Levels (EQ-5D-5L) scale, Mean change from baseline in EQ-5D-5L visual analog scale (VAS), Count and proportion of participants with Patient Global Impression of Change (PGIC) score of improved or better, Mean change from baseline in Fatigue Severity Scale (FSS) score, Mean change from baseline in Health-Related Productivity Questionnaire (HRPQ) outcomes, Effectiveness, side effects, convenience, and overall satisfaction scores as assessed by Treatment Satisfaction Questionnaire for Medications (TSQM)-14, Incidence of treatment-emergent adverse events (TEAEs) and treatment emergent serious adverse events (SAEs), Serum concentrations of DNTH103, Incidence and titer of antidrug antibody (ADA) levels against DNTH103

Source: https://euclinicaltrials.eu/ctis-public/view/2024-513128-40-00